EU clinical trial 2024-512881-32-00: Safety and immunogenicity of Shingrix vaccination in patients suffering from Psoriasis or Psoriatic arthritis
Protocol code: KKS-303
Sponsor: Justus-Liebig-Universitaet Giessen (Educational Institution). Phase: Therapeutic use (Phase IV). Countries: Germany (ongoing, recruiting).
Therapeutic area(s): Phenomena and Processes [G] - Immune system processes [G12]
Gender: Female, Male. Age: 18-64 years, 65+ years. Enrolment: 336.
Status: Ongoing, recruiting. Start date (EU): 2023-11-22. Decision date: 2024-09-26. Results received: No. Last updated: 2026-04-30.

Condition(s): Psoriasis vulgaris and/or psoriatric arthritis
Product: Shingrix powder and suspension for suspension for injection Herpes zoster vaccine (recombinant, adjuvanted)

Primary endpoint: Increase of Psoriasis arthritis and/or Psoriasis vulgaris activity under Shingrix vaccination defined as increase in DAPSA (by ≥ 15 points) or PASI (by ≥ 10 points) scores within 12 weeks after the first vaccination. If PsA activity arises in patients who only had Pso at inclusion or Pso activity arises in patients who only had PsA at inclusion, the trial steering committee will adjudicate whether this should be regarded as an increase in activity with respect to the primary endpoint.
Endpoint(s): Number of patients with humoral and cell-mediated vaccine response against the recombinant zoster vaccine (RZV) defined as increase in titer (anti VZV-ELISA) and/or glycoprotein E positive CD4-T-Cells) at 8 and at 52 weeks post first vaccination, Frequency, duration and maximum severity of patients with HZ and post-herpetic neuralgia during treatment phase & follow-up. HZ will be laboratory (PCR) confirmed. Post herpetic neuralgia is defined as pain ≥90 days after confirmed HZ onset. Ad-hoc visits at time of primarily suspected HZ will be performed., Frequency, duration and maximum severity of AEs/SAEs, together with measures of physical examination, vital signs, clinical chemistry, if deemed necessary, during treatment phase up to 60 days after second vaccination or after any doses., Frequency, duration and maximum severity of injection site reactions (by physical examination 7 days post-vaccination and patient reporting)

Source: https://euclinicaltrials.eu/ctis-public/view/2024-512881-32-00